EU clinical trial 2024-518965-85-00: The effects of rituximab and obinutuzumab on lymphocyte subsets in peripheral blood and lymphoid tissues of SLE patients
Sponsor: Amsterdam UMC Stichting (Patient organisation/association). Phase: Therapeutic use (Phase IV). Countries: Netherlands (authorised, recruiting).
Therapeutic area(s): Diseases [C] - Immune System Diseases [C20]
Gender: Female, Male. Age: 18-64 years, 65+ years. Enrolment: 20.
Status: Authorised, recruiting. Start date (EU): 2024-11-25. Decision date: 2024-11-25. Results received: No. Last updated: 2026-03-21.

Condition(s): Systemic lupus erythematodes
Product: RITUXIMAB, OBINUTUZUMAB

Primary endpoint: the proportion of patients with depletion of total CD19+ B cells in the peripheral blood (quantitative using highly-sensitivity flow cytometry) and lymph nodes, defined as a decrease of >2 points on a 4-point semi-quantitative scale. These will be separate co-primary endpoints. We will statistically test the difference in the proportions of patients with depletion by these criteria in RTX- versus OBI-treated patients,
Endpoint(s): Correlation between CD19+ lymphocyte (and other B lineage cells) depletion in peripheral blood/tissues and clinical response. Depletion (defined as a decrease of >2 points on a 4-point semi-quantitative scale of CD19+ cells in the lymph node) will be related to clinical response (defined as a >4 point improvement in cSLEDAI or any improvement in BILAG-2004 score) in a 2x2 chi-square test for all 20 patients. Changes in B lineage cells and associated T cell subsets in lymph nodes and skin of SLE

Source: https://euclinicaltrials.eu/ctis-public/view/2024-518965-85-00